EU clinical trial 2023-509739-22-00: A randomized, double-blind, placebo-controlled, parallel-group study to assess the efficacy, safety, and tolerability of dexpramipexole administered orally for 24 weeks in participants with eosinophilic asthma (EXHALE-4)
Protocol code: AR-DEX-22-03
Sponsor: Areteia Therapeutics Inc. (Pharmaceutical company). Phase: Therapeutic confirmatory (Phase III). Countries: Romania (ended), Poland (ended).
Therapeutic area(s): Diseases [C] - Respiratory Tract Diseases [C08]
Gender: Female, Male. Age: 0-17 years, 18-64 years, 65+ years. Enrolment: 25.
Status: Ended. Start date (EU): 2023-04-25. End date (EU): 2025-07-18. End date: 2025-07-31. Decision date: 2024-08-28. Results received: No. Last updated: 2025-07-14.
Decision dates by country: RO: 2024-08-28, PL: 2024-12-16

Condition(s): Eosinophilic asthma
Product: Dexpramipexole (KNS-760704), Placebo, Dexpramipexole (KNS-760704)

Primary endpoint: Pre-bronchodilator (pre-BD) FEV1, absolute change from baseline, averaged over Weeks 20 and 24.
Endpoint(s): Change from baseline in Asthma Control Questionnaire-6 (ACQ-6) averaged across visits at Weeks 20 and 24., Standardized version of the Asthma Quality of Life Questionnaire for 12 years and older (AQLQ+12) change from baseline to Week 24.

Source: https://euclinicaltrials.eu/ctis-public/view/2023-509739-22-00